EU clinical trial 2023-508271-36-00: Sterile allogeneic spongioflex® allografts as partial meniscal replacement after incomplete meniscal loss, an investigator-initiated trial
Sponsor: Dr. Sven Behrendt, Knie und Schulterchirurgie (Hospital/Clinic/Other health care facility). Phase: Therapeutic use (Phase IV). Countries: Germany (ongoing, recruiting).
Therapeutic area(s): Analytical,Diagnostic,Therapeutic Techniques and Equipment [E]-Surgical Procedures, Operative [E04]
Gender: Female, Male. Age: 18-64 years. Enrolment: 30.
Status: Ongoing, recruiting. Start date (EU): 2024-04-30. Decision date: 2024-03-15. Results received: No. Last updated: 2025-11-16.

Condition(s): incomplete meniscal loss
Product: HUMAN CANCELLOUS BONE

Primary endpoint: Improvement of PROMs (KOOS, IKDC, VAS Pain Score) 2 and 5 years after surgery compared to scores of the non-operated group and compared to pre-surgery scores.
Endpoint(s): Safety of the patient: Type, frequency and severity of treatment-related AEs and SAEs, Efficacy of the procedure: How many patients show a progression of osteoarthrosis up to TKA?, MRI evaluation: Outerbridge graduation, size of meniscus, number of patients with extrusion, size of extrusion after 6 weeks, 6 and 12 months (for operated patients) and after 2 and 5 years, comparison between the operated and the non-operated group, Patient satisfaction: very pleased, pleased, not pleased, very unsatisfied in the operated group after 2 and 5 years

Source: https://euclinicaltrials.eu/ctis-public/view/2023-508271-36-00